EU clinical trial 2023-508475-36-00: A Placebo-controlled, Double-blind, Randomized, Phase 3 Study to Evaluate the Effect of Obicetrapib/Ezetimibe Fixed Dose Combination Daily on Coronary Plaque Characteristics in Participants with Atherosclerotic Cardiovascular Disease on Coronary CT Angiography (REMBRANDT trial)
Protocol code: OBEZ-302
Sponsor: NewAmsterdam Pharma B.V. (Pharmaceutical company). Phase: Therapeutic confirmatory (Phase III). Countries: Czechia (ongoing, recruiting), Netherlands (ongoing, recruiting), Italy (ongoing, recruiting), Spain (ongoing, recruiting), Hungary (ongoing, recruiting), Poland (ongoing, recruiting).
Therapeutic area(s): Diseases [C] - Nutritional and Metabolic Diseases [C18]; Diseases [C] - Cardiovascular Diseases [C14]
Gender: Female, Male. Age: 18-64 years, 65+ years. Enrolment: 250.
Status: Ongoing, recruiting. Start date (EU): 2024-10-29. Decision date: 2024-07-22. Results received: No. Last updated: 2025-10-30.
Decision dates by country: IT: 2024-07-24, NL: 2024-07-23, ES: 2024-07-22, CZ: 2024-07-24, HU: 2024-07-23, PL: 2024-07-23

Condition(s): Atherosclerotic Cardiovascular Disease
Product: Placebo, Obicetrapib 10 mg + ezetimibe 10 mg fixed dose combination (FDC)

Primary endpoint: Percent change from baseline to 18 months in total NCPV in all major epicardial coronary arteries, as measured by CCTA, in participants treated with obicetrapib 10 mg + ezetimibe 10 mg FDC therapy compared with placebo.
Endpoint(s): Absolute change from baseline to 18 months in total NCPV in all major epicardial coronary arteries, as measured by CCTA, in participants treated with obicetrapib 10 mg + ezetimibe 10 mg FDC therapy compared with placebo, Percent change from baseline to 18 months in LDL-C in participants treated with obicetrapib 10 mg + ezetimibe 10 mg FDC therapy compared to placebo., Percent change from baseline to 18 months in non-calcified coronary atherosclerotic plaque volume in the most diseased coronary segment (NCPVMD), as measured by CCTA, in participants treated with obicetrapib 10 mg + ezetimibe 10 mg FDC therapy compared with placebo., Absolute change from baseline to 18 months in NCPVMD, as measured by CCTA, in participants treated with obicetrapib 10 mg + ezetimibe 10 mg FDC therapy compared with placebo., Change from baseline to 18 months in perivascular fat attenuation index (FAI), FAI score and its age- and gender-specific centile in the principal epicardial coronary arteries (left anterior descending [LAD], left circumflex [LCx], right coronary artery [RCA]) as measured by CCTA in participants treated with obicetrapib 10 mg + ezetimibe 10 mg FDC therapy compared with placebo., Exploratory Efficacy: To evaluate the absolute and percent change from baseline to 18 months in low attenuation plaque volume, calcified plaque volume and other relevant metrics as measured by CCTA in participants treated with obicetrapib 10 mg + ezetimibe 10 mg FDC therapy compared to placebo, Exploratory Efficacy: To evaluate the change from baseline to 18 months in radiotranscriptomic biomarkers of coronary inflammation (eg, C19RS) as measured by CCTA in participants treated with obicetrapib 10 mg + ezetimibe 10 mg FDC therapy compared to placebo, Exploratory Efficacy: To evaluate the following changes in laboratory parameters of lipoprotein metabolism in participants treated with obicetrapib 10 mg + ezetimibe 10 mg FDC therapy compared with placebo): o Percent change from baseline to Day 84 (Month 3) and 18 months in non-high-density lipoprotein cholesterol, apolipoprotein B, very-low-density lipoprotein cholesterol (VLDL-C), high-density lipoprotein cholesterol (HDL-C), LDL-C, small doteinense LDL-C, TG, apolipoprotein E, [., Exploratory Efficacy: To evaluate the effect from baseline of obicetrapib 10 mg + ezetimibe 10 mg FDC therapy on LDL-C, HDL-C, and VLDL-C particle numbers and size as measured by NMR analysis at 3 months (Day 84), Exploratory Efficacy: To evaluate the percent change from baseline to 18 months in biomarkers of glycemic control, including HbA1c, homeostatic model assessment of insulin resistance, and blood glucose after 18 months, Exploratory Efficacy: To evaluate the effect from baseline of obicetrapib 10 mg + ezetimibe 10 mg FDC therapy on aortic valve indices evaluated on CCTA at 18 months, Exploratory Efficacy: To evaluate the effect from baseline of obicetrapib 10 mg + ezetimibe 10 mg FDC therapy on lipid accumulation in circulating monocytes at 18 months. Furthermore, association between change in lipid-laden circulating monocytes and change in atherosclerotic plaque parameters will be evaluated. Note: endpoint for lymphocyte lipid substudy for participants in the European Union only.

Source: https://euclinicaltrials.eu/ctis-public/view/2023-508475-36-00